EU clinical trial 2024-512922-27-00: Glofitamab Combined With Pirtobrutinib in Relapsed/Refractory Patients with Mantle Cell Lymphoma Followed by an Extension in Treatment Naïve Patients (PLATO)
Protocol code: PLATO
Sponsor: Klinikum der Universitaet Muenchen AöR (Hospital/Clinic/Other health care facility). Phase: Therapeutic exploratory (Phase II). Countries: Denmark (authorised, recruitment pending), Sweden (ongoing, recruiting), Norway (authorised, recruitment pending), Germany (ongoing, recruiting), Spain (ongoing, recruiting).
Therapeutic area(s): Diseases [C] - Neoplasms [C04]
Gender: Female, Male. Age: 18-64 years, 65+ years. Enrolment: 96.
Start date (EU): 2025-11-25. Decision date: 2025-08-12. Results received: No. Last updated: 2026-05-22.
Decision dates by country: DK: 2025-08-12, SE: 2025-08-12, NO: 2025-08-13, ES: 2025-11-18, DE: 2025-08-15

Condition(s): Mantle Cell Lymphoma (MCL)
Product: PIRTOBRUTINIB, OBINUTUZUMAB, Columvi 10 mg concentrate for solution for infusion

Primary endpoint: The primary endpoint is progression-free survival status 24 months from treatment start and will be analyzed by cohort and stratum (cohort A, cohort B high-risk, and cohort B standard-risk). Analysis will be performed on a modified ITT population: eligible patients who received at least one dose of any IMP.
Endpoint(s): Progression free survival time from treatment start, Complete remission rate (CR) and overall response rate (ORR: CR, PR) 8 months from treatment start (after completion of glofitamab-treatment, prior to cycle 13) and approximately 24 months (prior to cycle 30) from treatment start., Rate of PET negative CR (complete metabolic response rate, Lugano criteria) 8 months from treatment start (after completion of glofitamab-treatment prior to cycle 13) and 24 months (prior to cycle 30) from treatment start, Best response, time to best response, time to first response from treatment start, Duration of response., Duration of CR, Overall survival (OS) time from treatment start, Safety: adverse events, serious adverse events, toxicities (CTCAE v5.0 and ASTCT 2019 for CRS/ICANS)

Source: https://euclinicaltrials.eu/ctis-public/view/2024-512922-27-00